EU clinical trial 2024-518180-35-00: Phase 2, randomized, double-blind, placebo-controlled study of IC0624 as first-line therapy in patients with active mild to moderate Hidradenitis Suppurativa (HS)
Protocol code: FD-069-169
Sponsor: Ichthyol-Gesellschaft Cordes Hermanni & Co. GmbH & Co. KG (Pharmaceutical company). Phase: Therapeutic exploratory (Phase II). Countries: Germany (ended).
Therapeutic area(s): Diseases [C] - Skin and Connective Tissue Diseases [C17]
Gender: Female, Male. Age: 18-64 years. Enrolment: 186.
Status: Ended. Start date (EU): 2025-03-03. End date (EU): 2026-01-08. Decision date: 2025-02-07. Results received: No. Last updated: 2025-09-04.

Condition(s): Hidradenitis Suppurativa
Product: ICHTHRALETTEN® 200 mg magensaftresistente Tabletten Wirkstoff: Natriumbituminosulfonat, Trockensubstanz, Ichthraletten - Placebo, Gastro Resistant Tablets

Primary endpoint: The primary endpoint will be the HiSCR50 at week 6.
Endpoint(s): Secondary efficacy endpoints: HiSCR50 at weeks 2 and 4; HiSCR75 at weeks 2, 4 and 6; AN (Abscesses and Inflammatory Nodules) count at weeks 2, 4 and 6; IHS4 at weeks 2, 4 and 6; Inflammation marker hsCRP at week 6 in comparison with baseline measurement at week 0, Secondary pain endpoint: Maximum daily pain sensation based on diary documentation within preceding 24 hours; Intake of pain medication for HS, Secondary safety and tolerability endpoints: (Serious) Adverse Events; Laboratory analysis at week 6 in comparison with analysis at week 0 (baseline) for liver transaminases (GGT, GOT/AST, GPT/ALT), creatinine, CK, HDL and LDL cholesterol, differential blood count., Secondary QoL endpoints: DLQI at week 6 in comparison with week 0 (past 7 days assessment); WHO-5 at week 6 in comparison with baseline at week 0; Indication of subjective satisfaction with the study treatment based on verbally asked questions at week 6

Source: https://euclinicaltrials.eu/ctis-public/view/2024-518180-35-00